EU clinical trial 2024-516605-23-00: A multicentre, open-label, Phase 3, randomised controlled trial of duvelisib versus investigator’s choice of gemcitabine or bendamustine in patients with relapsed/refractory nodal T cell lymphoma with T follicular helper (TFH) phenotype (TERZO)
Protocol code: SBI-0145-304
Sponsor: Secura Bio Limited (Pharmaceutical company). Phase: Therapeutic confirmatory (Phase III). Countries: Czechia (ongoing, recruiting), France (ongoing, recruiting), Spain (ongoing, recruiting), Germany (ongoing, recruiting), Poland (ongoing, recruiting), Netherlands (ongoing, recruiting), Italy (ongoing, recruiting), Belgium (ongoing, recruiting), Denmark (ongoing, recruiting).
Therapeutic area(s): Diseases [C] - Neoplasms [C04]
Gender: Female, Male. Age: 18-64 years, 65+ years. Enrolment: 94.
Status: Ongoing, recruiting. Start date (EU): 2025-05-12. Decision date: 2025-04-07. Results received: No. Last updated: 2026-06-25.
Decision dates by country: ES: 2025-04-07, DK: 2025-07-25, NL: 2025-04-08, IT: 2025-04-10, CZ: 2025-04-08, BE: 2025-07-16, PL: 2025-04-14, DE: 2025-04-08, FR: 2025-04-07

Condition(s): relapsed/refractory nodal T cell lymphoma with T follicular helper (TFH) phenotype, relapsed/refractory nodal T cell lymphoma with T follicular helper (TFH) phenotype
Product: BENDAMUSTINE, Copiktra 15 mg hard capsules, Copiktra 25 mg hard capsules, DUVELISIB, GEMCITABINE

Primary endpoint: Progression-free Survival (PFS) according to the Lugano 2014 criteria (Cheson 2014) as assessed by the Independent Review Committee (IRC) or death due to any cause - Up to 3 years
Endpoint(s): Overall Survival (OS) - Up to 3 years, PFS as assessed by the investigator - Up to 3 years, Objective Response Rate (ORR) as assessed by the IRC - Up to 3 years, Complete Response Rate (CRR) as assessed by the IRC - Up to 3 years, Duration of Response (DOR) as assessed by the IRC - Up to 3 years, Proportion of participants who proceed to Stem Cell Transplantation (SCT) - Up to 3 years, Investigator-assessed PFS in participants who proceed to SCT - Up to 3 years, Incidence/frequency of Adverse Events (AEs) and abnormal laboratory values - Up to 3 years, Quality of Life (QoL): European Organisation for Research and Treatment of Cancer (EORTC) QLQ-C30 Score - Up to 3 years, QoL: EQ5D Score - Up to 3 years, QoL: QLQ-NHL-HG29 Score - Up to 3 years, PK parameters derived from blood concentrations of duvelisib and its metabolites

Source: https://euclinicaltrials.eu/ctis-public/view/2024-516605-23-00